EU clinical trial 2024-516869-36-00: A Phase 1, dose determining study of EXS73565 in participants with relapsed or refractory B‑cell malignancies.
Protocol code: EXS73565-001
Sponsor: Exscientia AI Limited (Pharmaceutical company). Phase: Human Pharmacology (Phase I)- First administration to humans. Countries: Spain (ongoing, recruiting), France (authorised, recruitment pending), Greece (authorised, recruitment pending), Romania (authorised, recruitment pending), Poland (authorised, recruitment pending).
Therapeutic area(s): Diseases [C] - Hemic and Lymphatic Diseases [C15]
Gender: Female, Male. Age: 18-64 years, 65+ years. Enrolment: 101.
Start date (EU): 2025-02-17. Decision date: 2025-01-23. Results received: No. Last updated: 2026-05-18.
Decision dates by country: FR: 2026-05-11, GR: 2026-04-27, RO: 2026-05-18, PL: 2026-05-15, ES: 2025-01-23

Condition(s): Relapsed or refractory B-cell malignancies: chronic lymphocytic leukemia (CLL), including RT (Richter’s Transformation) from CLL, mantle-cell lymphoma (MCL), diffuse large B-cell lymphoma (DLBCL), follicular lymphoma (FL), marginal zone lymphoma (MZL)

Source: https://euclinicaltrials.eu/ctis-public/view/2024-516869-36-00